EU clinical trial 2025-522453-20-00: Individualized Intrathecal Chemotherapy Based on Measurement of Brain Fluid Clearance in Pediatric Patients
Sponsor: Oslo University Hospital HF (Hospital/Clinic/Other health care facility). Phase: Therapeutic exploratory (Phase II). Countries: Norway (authorised, recruitment pending).
Therapeutic area(s): Diseases [C] - Neoplasms [C04]; Diseases [C] - Nervous System Diseases [C10]
Gender: Female, Male. Age: 0-17 years. Enrolment: 50.
Status: Authorised, recruitment pending. Decision date: 2026-07-03. Results received: No. Last updated: 2026-08-04.

Condition(s): Acute lymphoblastic leukemia and lymphoma
Product: Gadobutrol 1.0 mmol/mL solution for injection

Primary endpoint: Exploratory model-derived BFC indices [absorption half-life (t½abs), time to maximal blood concentration (Tmax) of gadobutrol and maximum concentration (Cmax)] from the predefined gadobutrol popPK model using actual dose and sampling times.
Endpoint(s): Solicited AEs/AESIs Day 0-7, including headache, nausea, dizziness and other predefined symptoms; SAE/SUSAR occurrence; 30-minute post-dose observation findings., Mental Fatigue Scale score at 3 months., Change in neuropsychological test/questionnaire measures from baseline to 3 months and 2 years.

Source: https://euclinicaltrials.eu/ctis-public/view/2025-522453-20-00